EU clinical trial 2025-522167-15-00: A Randomized, Open-Label, Phase 3 Study of Rinatabart Sesutecan (Rina-S) Plus Standard of Care Versus Standard of Care as Maintenance Treatment After 2L PlatinumBased Doublet Chemotherapy in Participants With Recurrent Platinum-Sensitive Ovarian Cancer (PSOC)
Protocol code: GCT1184-04
Sponsor: Genmab A/S (Pharmaceutical company). Phase: Therapeutic confirmatory (Phase III). Countries: Finland (authorised, recruitment pending), Belgium (authorised, recruitment pending), Hungary (authorised, recruitment pending), France (authorised, recruitment pending), Denmark (authorised, recruitment pending), Austria (authorised, recruitment pending), Germany (authorised, recruitment pending), Italy (authorised, recruitment pending), Spain (authorised, recruitment pending), Czechia (authorised, recruitment pending), Norway (authorised, recruitment pending), Poland (authorised, recruitment pending).
Therapeutic area(s): Diseases [C] - Neoplasms [C04]
Gender: Female. Age: 18-64 years, 65+ years. Enrolment: 257.
Status: Authorised, recruitment pending. Decision date: 2026-07-01. Results received: No. Last updated: 2026-07-17.
Decision dates by country: AT: 2026-07-01, BE: 2026-07-01, CZ: 2026-07-02, DK: 2026-07-01, FR: 2026-07-01, DE: 2026-07-03, HU: 2026-07-08, IT: 2026-07-02, NO: 2026-07-01, PL: 2026-07-06, ES: 2026-07-09, FI: 2026-07-02

Condition(s): Ovarian Cancer Platinum-Sensitive Ovarian Cancer (PSOC)
Product: Rinatabart Sesutecan, BEVACIZUMAB

Primary endpoint: 1. PFS per Response Evaluation Criteria in Solid Tumours (RECIST) 1.1, as determined by blinded independent central review (BICR)
Endpoint(s): 1. Overall survival (OS) PFS, per RECIST 1.1, as determined by investigator assessment; Second determination of PFS (PFS2) Treatment-emergent adverse events, 2. Overall change from baseline in Global Health Status/Quality of Life (GHS/Qol) Score using the EORTC QLQ-C30 questionnaire Time to deterioration (TTD) in the GHS/Qol Scousing the EORTC QLQ-C30 questionnaire

Source: https://euclinicaltrials.eu/ctis-public/view/2025-522167-15-00